EU clinical trial 2024-517612-29-00: A Multicenter, Randomized, Double-Blind, Parallel Group, Placebo-Controlled Trial to Evaluate the Effect of In-Hospital Initiation of Dapagliflozin on Clinical Outcomes in Patients Who Have Been Stabilized During Hospitalization for Acute Heart Failure
Protocol code: D1690C00078
Sponsor: The Brigham And Women’s Hospital Inc. (Hospital/Clinic/Other health care facility). Phase: Phase III and phase IV (Integrated). Countries: Poland (ended), Hungary (ended), Czechia (ended).
Therapeutic area(s): Diseases [C] - Cardiovascular Diseases [C14]
Gender: Female, Male. Age: 18-64 years, 65+ years. Enrolment: 1000.
Status: Ended. Start date (EU): 2023-02-14. End date (EU): 2025-06-02. Decision date: 2024-11-15. Results received: Yes. Last updated: 2024-11-16.
Decision dates by country: CZ: 2024-11-15, HU: 2024-11-15, PL: 2024-11-16

Condition(s): acute heart failure
Product: Dapagliflozin Cipla 10 mg Filmtabletten, Matching placebo administered orally once daily for 2 months

Primary endpoint: Time to first occurrence of cardiovascular death or worsening heart failure defined as: 1. Worsening HF during the index admission requiring at least one of the following: a) initiation or re-initiation of inotropic therapy for ≥24 hours b) mechanical circulatory support c) invasive ventilatory support for heart failure d) heart transplantation, Time to first occurrence of cardiovascular death or worsening heart failure defined as: 2. Readmission for worsening heart failure, Time to first occurrence of cardiovascular death or worsening heart failure defined as: 3. Worsening heart failure leading to an urgent visit with administration of intravenous diuretic therapy (e.g., outpatient setting, emergency department) without associated hospital admission
Endpoint(s): Symptomatic hypotension leading to hospitalization or study drug discontinuation, Worsening renal function that results in at least a doubling of serum creatinine, hospitalization, study drug discontinuation, dialysis, or renal death

Source: https://euclinicaltrials.eu/ctis-public/view/2024-517612-29-00